EU clinical trial 2024-512804-20-00: AndroMETa-CRC-064: An Open Label, Randomized, Controlled, Global Phase 3 Study Comparing Telisotuzumab Adizutecan (ABBV-400) Monotherapy to LONSURF (Trifluridine and Tipiracil) plus Bevacizumab in Subjects with Refractory Metastatic Colorectal Cancer Expressing c-Met Protein Level Above a Defined Cutoff
Protocol code: M24-064
Sponsor: AbbVie Deutschland GmbH & Co. KG (Pharmaceutical company). Phase: Therapeutic confirmatory (Phase III). Countries: Germany (ended), Poland (ended), France (ended), Italy (ended), Netherlands (ended), Spain (ended).
Therapeutic area(s): Diseases [C] - Neoplasms [C04]
Gender: Female, Male. Age: 18-64 years, 65+ years. Enrolment: 87.
Status: Ended. End date (EU): 2026-05-01. Decision date: 2025-12-08. Results received: No. Last updated: 2026-05-27.
Decision dates by country: FR: 2025-12-10, DE: 2025-12-08, IT: 2025-12-09, ES: 2025-12-10, NL: 2025-12-10, PL: 2025-12-09

Condition(s): Metastatic Colorectal Cancer
Product: Lonsurf 15 mg/6.14 mg film-coated tablets, BEVACIZUMAB, Lonsurf 20 mg/8.19 mg film-coated tablets, BEVACIZUMAB, Telisotuzumab adizutecan

Primary endpoint: Stage 1: Percentage of Participants with Adverse Events (AE)s, Stage 1: Percentage of Participants with With Potentially Clinically Significant (PCS) Vital Sign Measurements as Assessed by the Investigator, Stage 1: Percentage of Participants with PCS Electrocardiograms (ECGs) Findings as Assessed by the Investigator, Stage 1: Percentage of Participants with PCS Laboratory Values (Chemistry, Hematology, Coagulation, and Urinalysis) as Assessed by the Investigator, Stage 1 and Stage 2: Objective Response (OR) as Assessed by Blinded Independent Central Review (BICR), Stage 2: Overall Survival (OS)
Endpoint(s): Stage 1 and Stage 2: Progression Free Survival (PFS) as Assessed by BICR, Stage 1: OS, Stage 1 and Stage 2: Duration of Response (DOR) as Assessed by BICR, Stage 1 and Stage 2: Disease Control (DC) as Assessed by BICR, Stage 1 and Stage 2: OR as Assessed by Investigator, Stage 1 and Stage 2: PFS as Assessed by Investigator, Stage 1 and Stage 2: DOR as Assessed by Investigator, Stage 1: Maximum Observed Serum (or Plasma, for Payload) Concentration (Cmax) for Telisotuzumab Adizutecan, Stage 1: Time to Cmax (Tmax) for Telisotuzumab Adizutecan, Stage 1: Terminal Elimination Half-Life (t1/2) for Telisotuzumab Adizutecan, Stage 1: Area Under the Serum (or Plasma, for Payload) Concentration Versus Time Curve (AUC) for Telisotuzumab Adizutecan, Stage 1: Antibody Drug Conjugate (ADC) for Telisotuzumab Adizutecan, Stage 1: Unconjugated Topoisomerase 1 (Top1) Inhibitor Payload for Telisotuzumab Adizutecan, Stage 1: Incidence of Anti-Drug Antibodies (ADAs) for Telisotuzumab Adizutecan, Stage 1: Neutralizing Anti-Drug Antibodies (nADAs) for Telisotuzumab Adizutecan, Stage 2: Change from Baseline at C5D1 in Physical Functioning as Measured by the Physical Functioning Domain of the European Organization for Research and Treatment of Cancer Quality of Life Questionnaire Core 30 (EORTC QLQC30), Stage 2: Change from Baseline at C7D1 (Standard of Care [SOC] Arm) in Physical Functioning as Measured by the Physical Functioning Domain of the EORTC QLQ-C30, Stage 2: Change from Baseline at C5D1 in in Diarrhea as Measured by the Physical Functioning Domain of the EORTC QLQ-C30, Stage 2: Change from Baseline at C7D1 (SOC Arm) in Diarrhea as Measured by the Physical Functioning Domain of the EORTC QLQ-C30, Stage 2: Change from Baseline at C5D1 in in Global Health Status (GHS)/QoL as Measured by the Physical Functioning Domain of the EORTC QLQ-C30, Stage 2: Change from Baseline at C7D1 (SOC Arm) in GHS/QoL as Measured by the Physical Functioning Domain of the EORTC QLQ-C30, Stage 1 and Stage 2: DC as Assessed by Investigator

Source: https://euclinicaltrials.eu/ctis-public/view/2024-512804-20-00